EU clinical trial 2023-504129-38-00: A Phase 2, Randomized, Double-Blind, Placebo-Controlled Study to Evaluate the Efficacy, Safety, and Tolerability of INCB000928 in Participants With Fibrodysplasia Ossificans Progressiva (PROGRESS)
Protocol code: INCB 00928-201
Sponsor: Incyte Corp. (Pharmaceutical company). Phase: Therapeutic exploratory (Phase II). Countries: France (ongoing, recruiting), Germany (ongoing, recruiting), Netherlands (ongoing, recruiting), Spain (ongoing, recruiting), Portugal (ended), Italy (ongoing, recruiting).
Therapeutic area(s): Diseases [C] - Musculoskeletal Diseases [C05]
Gender: Female, Male. Age: 0-17 years, 18-64 years, 65+ years. Enrolment: 18.
Start date (EU): 2022-03-31. Decision date: 2024-09-25. Results received: No. Last updated: 2026-08-03.
Decision dates by country: PT: 2024-11-04, ES: 2024-09-25, NL: 2024-09-26, FR: 2024-09-25, DE: 2024-09-27, IT: 2024-10-22

Condition(s): Fibrodysplasia Ossificans Progressiva
Product: Placebo, INCB000928

Primary endpoint: Occurrence of new HO lesions as assessed by low-dose WBCT (excluding the head) from baseline to Week 24.
Endpoint(s): • Number of new HO lesions as assessed by low-dose WBCT (excluding the head) from baseline to Week 24., • Total volume of new HO lesions as assessed by low-dose WBCT (excluding the head) from baseline to Week 24., • Change in the total volume of all HO lesions as assessed by low dose WBCT (excluding the head) from baseline to Week 24., • Number of new flares based on FOP PROMPT from baseline to Week 24., • AEs and SAEs, assessed by changes in vital signs, ECGs, echocardiograms, physical examinations, PFTs, BMD, laboratory data, and knee epiphyseal closure (2 to < 21 years of age)., • Occurrence of new HO lesions as assessed by low dose WBCT (excluding the head) from Week 24 to Week 48 compared to baseline to Week 24 in participants randomized to placebo during the DB period., • Number of new HO lesions as assessed by low-dose WBCT (excluding the head) from Week 24 to Week 48 compared to baseline to Week 24 in participants randomized to placebo during the DB period., • Total volume of new HO lesions as assessed by low-dose WBCT (excluding the head) from Week 24 to Week 48 compared to baseline to Week 24 in participants randomized to placebo during the DB period., • Change in the total volume of all HO lesions as assessed by low dose WBCT (excluding the head) from Week 24 to Week 48 compared to baseline to Week 24 in participants randomized to placebo during the DB period., INCB000928 PK parameters in plasma and/or saliva: Cmax, tmax, Cmin, and AUCt., • Number of new flares based on FOP PROMPT from Week 24 to Week 48 compared to baseline to Week 24 in participants randomized to placebo during the DB period

Source: https://euclinicaltrials.eu/ctis-public/view/2023-504129-38-00